EU clinical trial 2023-509755-13-00: BOOSTER – Multicenter, Open Label, Randomized Control Phase III Trial Comparing the Efficacy and Safety of Two Rituximab Regimens in Maintenance Therapy for Relapsing Nephrotic Syndrome Due to Podocytopathies in Adults.
Protocol code: 2023-002
Sponsor: Medical University Of Lodz (Educational Institution). Phase: Therapeutic confirmatory (Phase III). Countries: Poland (ongoing, recruiting).
Therapeutic area(s): Diseases [C] - Pathological Conditions, Signs and Symptoms [C23]
Gender: Female, Male. Age: 18-64 years, 65+ years. Enrolment: 70.
Status: Ongoing, recruiting. Start date (EU): 2025-04-28. Decision date: 2025-02-10. Results received: No. Last updated: 2026-07-29.

Condition(s): Idiopathic steroid-sensitive nephrotic syndrome
Product: RITUXIMAB

Primary endpoint: Time from randomization to first relapse of nephrotic syndrome (non-inferiority hypothesis).
Endpoint(s): Time from randomization to first relapse of nephrotic syndrome (superiority hypothesis)., Percentage of nephrotic syndrome relapse within 24 months., Cumulative dose of glucocorticoids administered within 24 months of randomization., Absolute values and differences from the entry assessment in the number of points obtained in the EQ-index (EQ-index) and analog scale (EQ-VAS) according to the EQ-5D-5L questionnaire at 24 months after randomization., Severe adverse event rate., Rate of adverse events of special interest., Time from randomization to the first relapse of nephrotic syndrome or subnephrotic proteinuria

Source: https://euclinicaltrials.eu/ctis-public/view/2023-509755-13-00